EU clinical trial 2024-514581-39-00: Therapeutic vaccination: Phase I / II clinical study on patients randomized blinded to the experimental vaccine or placebo regimen. we want to evaluate the safety and the immunogenicity of a vaccine that includes a first administration of the ChAdOx1.tHIVconsvX product and a second one with MVA.tHIVconsvX in HIV-1 positive adults treated early and able to control the infection for a long time.
Sponsor: Ospedale San Raffaele S.r.l. (Hospital/Clinic/Other health care facility). Phase: Phase I and Phase II (Integrated)- First administration to humans. Countries: Italy (ongoing, recruitment ended).
Therapeutic area(s): Diseases [C] - Virus Diseases [C02]
Gender: Female, Male. Age: 18-64 years. Enrolment: 33.
Status: Ongoing, recruitment ended. Start date (EU): 2023-11-08. Decision date: 2024-08-05. Results received: No. Last updated: 2024-08-05.

Condition(s): HIV Infection

Source: https://euclinicaltrials.eu/ctis-public/view/2024-514581-39-00